EU clinical trial 2025-521305-40-00: A study to test the safety and efficacy of EP102 in patients with advanced solid tumours
Sponsor: Epics Therapeutics (Pharmaceutical company). Phase: Human Pharmacology (Phase I)- First administration to humans. Countries: Spain (ongoing, recruiting), Czechia (ongoing, recruiting), Belgium (ongoing, recruiting), Netherlands (ongoing, recruiting), France (ended).
Therapeutic area(s): Not possible to specify
Gender: Female, Male. Age: 18-64 years, 65+ years. Enrolment: 92.
Start date (EU): 2025-07-22. Decision date: 2025-07-15. Results received: No. Last updated: 2026-04-13.
Decision dates by country: FR: 2025-10-29, BE: 2025-07-15, CZ: 2025-07-15, ES: 2025-07-16, NL: 2025-07-21

Condition(s): Participants with Advanced Solid Tumors

Source: https://euclinicaltrials.eu/ctis-public/view/2025-521305-40-00